EU clinical trial 2025-523054-14-00: Randomized, open-label, replicated single-dose, 4-period, 2-sequence crossover study to assess the comparative bioavailability of test product Amlodipine/Valsartan/Hydrochlorothiazide 10 mg/160 mg/12.5 mg film-coated tablets to reference product Exforge HCT 10 mg/160 mg/12.5 mg film-coated tablets in healthy male and female subjects under fasting conditions.
Sponsor: Pharma Start LLC (Pharmaceutical company). Phase: Human Pharmacology (Phase I)- Bioequivalence Study. Countries: Czechia (ended).
Therapeutic area(s): Diseases [C] - Cardiovascular Diseases [C14]
Gender: Female, Male. Age: 18-64 years. Enrolment: 42.
Status: Ended. Start date (EU): 2025-09-15. End date (EU): 2025-12-09. Decision date: 2025-08-28. Results received: No. Last updated: 2025-12-02.
Decision dates by country: CZ: 2025-09-01

Condition(s): not applicable (submitted trial is bioavailability)

Source: https://euclinicaltrials.eu/ctis-public/view/2025-523054-14-00